EU clinical trial 2025-524298-18-00: A phase 2b, single-center, randomized, double-blind, placebo-controlled study to assess the efficacy and safety of oral Ladarixin in association with a single low dose of Antithymocyte Globulin in patients with new-onset autoimmune type 1 diabetes.
Protocol code: ATGLDX1-2025
Sponsor: Ospedale San Raffaele S.r.l. (Hospital/Clinic/Other health care facility). Phase: Therapeutic exploratory (Phase II). Countries: Italy (not authorised).
Therapeutic area(s): Diseases [C] - Immune System Diseases [C20]
Gender: Female, Male. Age: 0-17 years, 18-64 years. Enrolment: 46.
Status: Not authorised. Decision date: 2026-04-09. Results received: No. Last updated: 2026-04-09.

Condition(s): new-onset autoimmune type 1 diabetes
Product: Microcrystalline cellulose, Lactose monohydrate, Croscarmellose Sodium, Hydroxypropyl cellulose, Citric acid monohydrate, Magnesium Stearate, RABBIT ANTI-HUMAN THYMOCYTE IMMUNOGLOBULIN, Ladarixin

Primary endpoint: The primary endpoint of the study is the change from baseline in the area under the stimulated C-peptide curve (YAUC) at 2 hour MMTT conducted at the 12 month visit.
Endpoint(s): Changes in: 1) fasting and stimulated C-peptide 2) HbA1c 3) daily insulin requirements throughout the study 4) time in range (70-180 mg/dl), time in tight range (70-140 mg/dl), time below range (<70 mg/dl), glucose management index by CGM and %CV as measure of glucose variability 5) QoL, patient treatment satisfaction and fear of hypoglycemia will be assessed using the Diabetes-Specific Quality of Life (DSQoL) Questionnaire and the FH-15 Questionnaire, both validated in Italian. 6) a

Source: https://euclinicaltrials.eu/ctis-public/view/2025-524298-18-00